EU clinical trial 2024-515909-26-00: RINGSIDE: A Phase 2/3, Randomized, Multicenter Study to Evaluate AL102 in Patients with Progressing Desmoid Tumors
Protocol code: AL-DES-01
Sponsor: Immunome Inc. (Pharmaceutical company). Phase: Phase II and Phase III (Integrated). Countries: Netherlands (ongoing, recruitment ended), Poland (ongoing, recruitment ended), Belgium (ongoing, recruitment ended), Italy (ongoing, recruitment ended), Germany (ongoing, recruitment ended), Spain (ongoing, recruitment ended).
Therapeutic area(s): Diseases [C] - Neoplasms [C04]
Gender: Female, Male. Age: 0-17 years, 18-64 years, 65+ years. Enrolment: 63.
Status: Ongoing, recruitment ended. Start date (EU): 2022-01-26. Decision date: 2024-10-30. Results received: No. Last updated: 2026-07-24.
Decision dates by country: ES: 2024-11-12, DE: 2024-11-13, IT: 2024-11-19, PL: 2024-12-09, NL: 2024-10-30, BE: 2024-10-30

Condition(s): Progressing desmoid tumors
Product: AL102, AL102, Placebo capsule

Primary endpoint: Part A: Frequency and severity of TEAEs and SAEs; time to treatment discontinuation due to TEAE, Part B: Progression free survival, OLE: Frequency and severity of TEAEs and SAEs
Endpoint(s): Part A: change from baseline to week 16 in tumor volume, Part B: proportion of subjects with confirmed ORR, Part B: duration of response, Part B: PFS as defined as the time from randomization until the date of radiographic progression by BICR or clinical progression, Part B: Change from baseline at Week 24 in estimated tumor volume, Part B: Change from baseline to Week 12 in the worst pain intensity (WPI), Part B: frequency and severity of TEAEs and SAEs, Part B: time to treatment discontinuation due to TEAE, OLE: PFS as defined as the time of radiographic progression, OLE: Proportion of subjects with confirmed ORR (CR and PR) by BICR based on RECIST v1.1, OLE: DOR as defined by the time from confirmed OOR (CR or PR) by BICR based on RECIST v1.1 until the earlier of the first documentation of disease progression or death from any cause, OLE: PFS as defined as the time to radiographic progression as assessed by BICR based on RECIST v1.1, OR clinical progression, OLE: Change from baseline (defined as from the start of AL102 treatment) in − Quality of life as determined by GODDESS DTSS Total Symptom Score − GODDESS DTIS Physical Functioning Domain Score − WPI using GODDESS DTSS Item 1

Source: https://euclinicaltrials.eu/ctis-public/view/2024-515909-26-00